EU clinical trial 2025-521495-54-00: A Phase 3, Multicenter, Randomized, Double-Blind, Placebo-Controlled Study to Evaluate the Efficacy and Safety of Enlicitide Decanoate Coadministered With Rosuvastatin in Adults With Hyperlipidemia
Protocol code: MK-0616-037
Sponsor: Merck Sharp & Dohme LLC (Pharmaceutical company). Phase: Therapeutic confirmatory (Phase III). Countries: Spain (ongoing, recruitment ended), Hungary (ongoing, recruitment ended).
Therapeutic area(s): Diseases [C] - Cardiovascular Diseases [C14]
Gender: Female, Male. Age: 18-64 years. Enrolment: 120.
Status: Ongoing, recruitment ended. Start date (EU): 2025-12-20. Decision date: 2025-11-19. Results received: No. Last updated: 2026-06-05.
Decision dates by country: HU: 2025-11-24, ES: 2025-11-19

Condition(s): Hyperlipidemia
Product: Rosuvastatin Placebo, ROSUVASTATIN, MK-0616 (Enlicitide decanoate) placebo, MK-0616

Primary endpoint: Mean Percent Change from Baseline in Low-Density Lipoprotein Cholesterol (LDL-C) at Week 8 (Enlicitide + Rosuvastatin Versus Placebo)
Endpoint(s): Mean Percent Change from Baseline in LDL-C at Week 8, Mean Percent Change from Baseline in Apolipoprotein B (ApoB) at Week 8, Number of Participants with One or More Adverse Events (AEs), Number of Participants who Discontinue Study Drug Due to One or More AEs, Mean Percent Change from Baseline in LDL-C at Week 12, Mean Percent Change from Baseline in Non-High-Density Lipoprotein Cholesterol (non-HDL-C) at Week 8, Percent Change from Baseline in Lipoprotein (a) (Lp[a]) at Week 8, Percentage of Participants with LDL-C <70 mg/dL and ≥50% Reduction from Baseline at Week 8, Percentage of Participants with LDL-C <55 mg/dL and ≥50% Reduction from Baseline at Week 8

Source: https://euclinicaltrials.eu/ctis-public/view/2025-521495-54-00